EU clinical trial 2024-516586-37-00: Clofarabine Therapy in Patients with Locally Advanced or Metastatic Urothelial Carcinoma: a Phase 1/2 Dose-Escalation Study
Sponsor: Medical University Of Vienna (Educational Institution). Phase: Phase I and Phase II (Integrated)- Other. Countries: Austria (ongoing, recruiting).
Therapeutic area(s): Diseases [C] - Neoplasms [C04]
Gender: Female, Male. Age: 18-64 years, 65+ years. Enrolment: 50.
Status: Ongoing, recruiting. Start date (EU): 2023-10-24. Decision date: 2024-10-14. Results received: No. Last updated: 2024-10-14.

Condition(s): Urothelial carcinoma
Product: Evoltra 1 mg/ml concentrate for solution for infusion

Primary endpoint: Maximum tolerated dose (MTD)
Endpoint(s): Objective response (OR) determined by Response Evaluation Criteria in Solid Tumors (RECIST) 1.1, Duration of response (DOR) (radiographic), Time to progression (radiographic), Progression-free survival (PFS), Overall survival (OS), Treatment-related adverse events evaluated using the National Cancer Institute’s Common Terminology Criteria for Adverse Events (version 5.0), Pharmacokinetics parameters of Clofarabine including maximum serum concentration (Cmax) and area under the concentration-time curve (AUC)

Source: https://euclinicaltrials.eu/ctis-public/view/2024-516586-37-00